EU clinical trial 2023-504901-34-00: Bioequivalence of Betis®10 mg Film-Coated Tablets versus Clozan 10 mg tablets in Healthy Subjects
Protocol code: BLCL-CLT-01
Sponsor: Synthon Chile LTDA. (Pharmaceutical company). Phase: Human Pharmacology (Phase I)- Bioequivalence Study. Countries: Portugal (ended).
Therapeutic area(s): Not possible to specify
Gender: Female, Male. Age: 18-64 years. Enrolment: 44.
Status: Ended. Start date (EU): 2024-07-15. End date (EU): 2024-12-02. Decision date: 2024-05-14. Results received: No. Last updated: 2025-01-22.

Condition(s): No medical condition.

Source: https://euclinicaltrials.eu/ctis-public/view/2023-504901-34-00